EU clinical trial 2024-515869-33-00: A Phase 3a, observer-blind, randomized, controlled study to demonstrate lot-to-lot consistency and evaluate the immunogenicity and safety of an investigational varicella vaccine compared with Varivax, administered as a first dose to healthy children 12 to 15 months of age.
Protocol code: 213998 (VNS 20-002)
Sponsor: GlaxoSmithKline Biologicals (Pharmaceutical company). Phase: Therapeutic confirmatory (Phase III). Countries: Czechia (ongoing, recruiting), Poland (ongoing, recruiting), Estonia (ongoing, recruiting), Belgium (ongoing, recruiting).
Therapeutic area(s): Diseases [C] - Virus Diseases [C02]
Gender: Female, Male. Age: 0-17 years. Enrolment: 301.
Status: Ongoing, recruiting. Start date (EU): 2025-07-08. Decision date: 2025-05-13. Results received: No. Last updated: 2026-08-06.
Decision dates by country: BE: 2025-05-13, CZ: 2025-05-14, EE: 2025-05-16, PL: 2025-05-19

Condition(s): Varicella
Product: VARIVAX® Pulver und Lösungsmittel zur Herstellung einer Injektionssuspension in einer Fertigspritze Varizellen-Lebendimpfstoff, VARIVAX® Pulver und Lösungsmittel zur Herstellung einer Injektionssuspension in einer Fertigspritze Varizellen-Lebendimpfstoff

Primary endpoint: Percentage of participants with seroresponse to Varicella Zoster Virus (VZV) anti- glycoprotein E (gE) Immunoglobulin (IgG) for the 3 lots of VNS vaccine groups. Time frame: At Day 43, Geometric Mean Concentration (GMC) of anti-VZV gE IgG for the 3 lots of VNS vaccine groups. Time time frame: At Day 43, Percentage of participants with seroresponse to anti-VZV gE IgG for the 3 pooled lots of VNS vaccine groups compared with the 2 pooled lots of VV group. Time frame: At day 43., GMCs of anti-VZV gE IgG for the 3 pooled lots of VNS vaccine groups compared with the 2 pooled lots of VV group. Fime frame: At Day 43.
Endpoint(s): Anti-measles antibodies GMCs for the 3 pooled lots of VNS vaccine groups compared with the 2 pooled lots of VV group. Time frame: At Day 43, Anti-mumps antibodies GMCs for the 3 pooled lots of VNS vaccine groups compared with the 2 pooled lots of VV group. TIme frame: At Day 43, Anti-rubella antibodies GMCs for the 3 pooled lots of VNS vaccine groups compared with the 2 pooled lots of VV group. Time frame: At Day 43, Percentage of participants with seroresponse to anti-measles for the 3 pooled lots of VNS vaccine groups compared with the 2 pooled lots of VV group. Time frame: At Day 43., Percentage of participants with seroresponse to anti-mumps for the 3 pooled lots of VNS vaccine groups compared with the 2 pooled lots of VV group. Time frame: At Day 43, Percentage of participants with seroresponse to anti-rubella for the 3 pooled lots of VNS vaccine groups compared with the 2 pooled lots of VV group. Time frame: At Day 43., Anti-Hepatitis A antibodies GMCs for the 3 pooled lots of VNS vaccine groups compared with the 2 pooled lots of VV group in HAV subset. Time frame: At Day 43., Percentage of participants with seroresponse to anti-HAV for the 3 pooled lots of VNS vaccine groups compared with the 2 pooled lots of VV group in HAV subset. Time frame: At day 43., Anti-S. pneumoniae serotype specific Polysaccharide IgG antibody concentrations for the 3 pooled lots of VNS vaccine groups compared with the 2 pooled lots of VV group in PCV subset. Time frame: At Day 43., Percentage of participants in the VNS vaccine pooled group with anti-VZV gE antibody concentrations above the adaptive seroresponse threshold. Time frame: At Day 43., Percentage of participants reporting each solicited administration site events (injection site redness, pain and swelling). Time frame: Day 1 (post-dose) to Day 4., Percentage of participants reporting each solicited systemic event (drowsiness, loss of appetite and irritability). Time frame: Day 1 (post-dose) to Day 15., Percentage of participants reporting each solicited systemic event in terms of fever (Fever is defined as temperature greater than or equal to [>=)] 38.0 degrees Celsius [°C] by any route). Time frame: Day 1 (post-dose) to Day 22., Percentage of participants reporting each solicited administration site events (injection site varicella-like rash). Time frame: Day 1 (post-dose) to Day 43., Percentage of participants reporting each solicited systemic events (varicella-like rash [non-injection site] and general rash [not varicella like]). Time frame: Day 1 (post-dose) to Day 43., Percentage of participants reporting unsolicited adverse events (AEs) (any AE reported in addition to solicited events during the study, or any "solicited" symptoms with onset outside of the specified period of follow-up for solicited symptoms). Time frame: Day 1 (post-dose) to Day 43., Percentage of participants reporting medically attended AEs (MAAE) (A MAAE is an AE for which the participant received medical attention including any symptom or illness requiring hospitalization, or an emergency room visit, or visit to/by a healthcare professional.). Time frame: Day 1 (post-dose) to Day 181 (study end)., Percentage of participants reporting serious adverse events (SAEs). (A SAE is an AE which results in death, is life-threatening, requires inpatient hospitalization or prolongation of existing hospitalization, results in disability/incapacity, or other situations that are considered serious per medical or scientific judgment.). Time frame: Day 1 (post-dose) to Day 181 (study end).

Source: https://euclinicaltrials.eu/ctis-public/view/2024-515869-33-00